EU clinical trial 2024-512657-24-00: ALL SCTped 2012 FORUM - Allogeneic Stem Cell Transplantation in Children and Adolescents with Acute Lymphoblastic Leukaemia
Protocol code: ALL SCTped FORUM
Sponsor: St. Anna Childrens Cancer Research Institute GmbH (Pharmaceutical company). Phase: Phase II and Phase III (Integrated). Countries: Italy (ongoing, recruiting), Norway (ongoing, recruiting), Slovakia (ongoing, recruiting), Austria (ongoing, recruiting), Belgium (ongoing, recruiting), Germany (ongoing, recruitment ended), France (ongoing, recruitment ended), Spain (ongoing, recruiting), Sweden (ongoing, recruiting), Czechia (ongoing, recruiting), Netherlands (ongoing, recruiting), Denmark (ongoing, recruiting).
Therapeutic area(s): Diseases [C] - Neoplasms [C04]; Diseases [C] - Hemic and Lymphatic Diseases [C15]
Gender: Female, Male. Age: 0-17 years, 18-64 years. Enrolment: 1108.
Start date (EU): 2014-03-27. Decision date: 2024-10-09. Results received: No. Last updated: 2026-04-17.
Decision dates by country: AT: 2024-10-14, BE: 2024-10-09, DK: 2024-10-10, IT: 2024-11-25, ES: 2024-10-10, SE: 2024-10-11, NO: 2024-10-10, SK: 2024-10-09, CZ: 2024-10-11, NL: 2024-10-09, FR: 2024-11-13, DE: 2024-10-16

Condition(s): Acute Lymphoblastic Leukaemia
Product: CYCLOPHOSPHAMIDE, ANTI-HUMAN T-LYMPHOCYTE IMMUNOGLOBULIN FROM RABBITS, RABBIT ANTI-HUMAN THYMOCYTE IMMUNOGLOBULIN, THIOTEPA, FLUDARABINE PHOSPHATE, TREOSULFAN, BLINCYTO 38.5 micrograms powder for concentrate and solution for solution for infusion., BUSULFAN, ETOPOSIDE

Primary endpoint: Stratum 1: Overall Survival (OS), Stratum 2: Event Free Survival (EFS)
Endpoint(s): Stratum 1: EFS, Stratum 2: OS, Stratum 1 and 2: Cumulative Incidence of Treatment-related mortality (TRM), Stratum 1 and 2: Cumulative Incidence of Relapse, Stratum 1 and 2: Toxicity: acute and late, Stratum 1 and 2: Acute Graft versus Host Disease (aGVHD) and chronic GVHD (cGvHD), Stratum 1 and 2: Secondary malignancies

Source: https://euclinicaltrials.eu/ctis-public/view/2024-512657-24-00